EU clinical trial 2026-526179-49-00: Non-inferiority of surgical treatment of cartilage defects of the knee with autologous minced cartilage implantation (AMCI) and matrix-asscociated autologous chondrocyte implantation with respect to KOOS at 24 months (M ACI) - MinCaRCT
Protocol code: P00094
Sponsor: Medical Center - University Of Freiburg (Hospital/Clinic/Other health care facility). Phase: Therapeutic use (Phase IV). Countries: Germany (authorised, recruitment pending).
Therapeutic area(s): Diseases [C] - Musculoskeletal Diseases [C05]
Gender: Female, Male. Age: 18-64 years. Enrolment: 166.
Status: Authorised, recruitment pending. Decision date: 2026-08-03. Results received: No. Last updated: 2026-08-03.

Condition(s): Full-thickness cartilage defects of the knee
Product: MACI 500,000 to 1,000,000 cells/cm2 implantation matrix, Spherox 10-70 spheroids/cm2 implantation suspension

Primary endpoint: The primary efficacy endpoint is the KOOS5 (composite Knee injury and Osteoarthritis Outcome Score) at 24 months after randomisation
Endpoint(s): Following scores and questionnaires at 3, 6, 12, 24 months after randomisation: IKDC, KOOS5, KOOS subscales (Pain, Symptoms, ADL, Sport and Recreation, QOL), Lysholm, QOL SF-12, absence from work and incidence and number of revision surgeries.

Source: https://euclinicaltrials.eu/ctis-public/view/2026-526179-49-00